EU clinical trial 2025-523032-39-00: Improved baseline staging with 68Ga-FAPI-46 PET in non-small cell lung cancer – a pilot study
Sponsor: Academisch Ziekenhuis Maastricht (Hospital/Clinic/Other health care facility). Phase: Therapeutic exploratory (Phase II). Countries: Netherlands (authorised, recruitment pending).
Therapeutic area(s): Analytical, Diagnostic and Therapeutic Techniques and Equipment [E] - Diagnosis [E01]; Diseases [C] - Neoplasms [C04]
Gender: Female, Male. Age: 18-64 years, 65+ years. Enrolment: 10.
Status: Authorised, recruitment pending. Decision date: 2026-02-03. Results received: No. Last updated: 2026-02-03.

Condition(s): Non-small cell lung cancer
Product: 68Ga-FAPI-46, Steripet 250 MBq/ml Oplossing voor injectie

Primary endpoint: Determining essential input parameters for the calculation of an appropriate sample size for a future prospective diagnostic study, Number and location of metastatic lesions that are detected on the 68Ga-FAPI-46 PET (measure of interest) but not on the 18F-FDG PET in combination with brain MRI (current standard of care), Number and location of metastatic lesions detected on the 18F FDG PET in combination with brain MRI (current standard of care) but not on 68Ga-FAPI-46 PET (measure of interest)
Endpoint(s): Number of patients with brain metastases on brain MRI (standard of care) and on 68Ga-FAPI-46 PET (measure of interest), In patients with brain metastases: number of brain metastases on brain MRI (standard of care) and on 68Ga-FAPI-46 PET (measure of interest), Number of patients with at least one 68Ga-FAPI-positive, 18F-FDG-negative lesion for which an additional investigation is clinically necessary, Number of patients whose disease stage is upstaged based on 68Ga-FAPI-46 PET/CT findings compared to staging based on 18F-FDG PET/CT and brain MRI

Source: https://euclinicaltrials.eu/ctis-public/view/2025-523032-39-00